EU clinical trial 2023-507213-97-00: First in human study of the infusion of ARI0003 cells in relapsed/refractory to treatment B-cell aggressive lymphoma
Sponsor: Fundacio De Recerca Clinic Barcelona-Institut D’investigacions Biomediques August Pi I Sunyer (Laboratory/Research/Testing facility). Phase: Human Pharmacology (Phase I)- First administration to humans. Countries: Spain (ongoing, recruiting).
Therapeutic area(s): Diseases [C] - Neoplasms [C04]
Gender: Female, Male. Age: 18-64 years, 65+ years. Enrolment: 58.
Status: Ongoing, recruiting. Start date (EU): 2024-05-09. Decision date: 2024-01-08. Results received: No. Last updated: 2026-07-01.

Condition(s): Relapsed/refractory B-cell aggressive lymphoma

Source: https://euclinicaltrials.eu/ctis-public/view/2023-507213-97-00